EU clinical trial 2024-518811-20-00: A Phase II, Open-Label, Multicenter Study Evaluating the Safety and Efficacy of Neoadjuvant Treatment with Inavolisib Combinations in Patients with Untreated, Early-Stage, PIK3CA-Mutated Breast Cancer
Protocol code: BO45853
Sponsor: F. Hoffmann-La Roche AG (Pharmaceutical company). Phase: Therapeutic exploratory (Phase II). Countries: Germany (ongoing, recruiting), Spain (ongoing, recruiting).
Therapeutic area(s): Diseases [C] - Neoplasms [C04]
Gender: Female. Age: 18-64 years, 65+ years. Enrolment: 34.
Status: Ongoing, recruiting. Start date (EU): 2025-09-30. Decision date: 2025-07-01. Results received: No. Last updated: 2026-03-18.
Decision dates by country: ES: 2025-07-22, DE: 2025-08-01

Condition(s): Early-Stage, PIK3CA-Mutated Breast Cancer (BC)
Product: LETROZOLE ACCORD HEALTHCARE 2,5 mg, comprimé pelliculé, Kisqali 200 mg film-coated tablets, RIBOCICLIB, INAVOLISIB, RIBOCICLIB, LETROZOLE, INAVOLISIB, LETROZOLE, Letrozol STADA® 2,5 mg Filmtabletten

Primary endpoint: Incidence and severity of adverse events, with severity determined according to NCI CTCAE v5.0 grading scale, Change from baseline in selected clinical laboratory test results, Tolerability, as assessed by the overall treatment exposure and the incidence of dose modifications and treatment discontinuation due to adverse events
Endpoint(s): Pathologic Complete Response (pCR) rate in breast and axilla (ypT0/Tis ypN0) according to local pathologist assessment following the American Joint Committee on Cancer (AJCC) TNM staging system (Amin et al. 2017; NCCN 2024), Tumor overall objective response rate (ORR), Changes in Ki-67 by immunohistochemistry (IHC), Presence, frequency of occurrence, severity, and/or degree of interference with daily function of selected symptomatic treatment toxicities as assessed through use of the National Cancer Institute Patient-Reported Outcomes version of the Common Terminology Criteria for Adverse Events (NCI PRO-CTCAE), Proportion of participants reporting each response option at each assessment timepoint for treatment side-effect bother single-item General Population, Question 5 (GP5) from the Functional Assessment of Cancer Therapy-General (FACT-G), Change from baseline/worsening in symptomatic treatment toxicities and treatment side-effect bother as assessed through use of PRO-CTCAE and the FACT-G GP5 item

Source: https://euclinicaltrials.eu/ctis-public/view/2024-518811-20-00